EU clinical trial 2026-525223-24-00: A randomized phase II study comparing the safety and efficacy of mifamurtide and standard therapy containing sorafenib in pediatric and young adult patients with high-risk osteosarcoma
Protocol code: DRAGONFLY
Sponsor: Instytut Matki I Dziecka (Hospital/Clinic/Other health care facility). Phase: Therapeutic exploratory (Phase II). Countries: Poland (ongoing, recruiting).
Therapeutic area(s): Diseases [C] - Neoplasms [C04]
Gender: Female, Male. Age: 0-17 years, 18-64 years. Enrolment: 40.
Status: Ongoing, recruiting. Start date (EU): 2026-06-23. Decision date: 2026-04-20. Results received: No. Last updated: 2026-06-23.

Condition(s): Relapsed/refractory osteosarcoma, High-grade osteosarcoma
Product: SORAFENIB, MIFAMURTIDE

Primary endpoint: EFS (Event-Free Survival) – the time from randomization to the first event, i.e., death, disease progression, or disease relapse, whichever occurs first. Assessment will be conducted from the date of randomization to the date of the event or to the date of the last available assessment.
Endpoint(s): OS (Overall Survival) – Overall survival will be measured from randomization to death from any cause; for patients alive at the end of follow-up, data will be censored at the date of last confirmed contact., PFS (Progression-Free Survival) – Progression-free survival will be measured from randomization to the date of disease progression or death, whichever occurs first., ORR (Overall Response Rate) – Response rate, defined as the percentage of patients with the best documented complete response (CR) or partial response (PR), assessed according to RECIST v1.1 at the time points specified in the imaging schedule., Evaluation of the safety of mifamurtide in patients with osteosarcoma. Safety will be assessed based on the number of serious adverse events (SAEs), the number of adverse events (AEs), a physical examination with analysis of recorded vital signs and laboratory abnormalities according to NCI CTCAE v5.0, from the start of treatment to the end of safety follow-up according to the study schedule.

Source: https://euclinicaltrials.eu/ctis-public/view/2026-525223-24-00